EU clinical trial 2023-510338-10-00: Multicenter, randomised, open-label with blind evaluation active and placebo-controlled, non-inferiority clinical trial to investigate the efficacy and tolerability of Lipovir® Gel (Acyclovir 5%) compared to Zovirax® Cream (Acyclovir 5%) on patients with Recurrent Herpes Labialis
Protocol code: OP-LIPC02
Sponsor: Laboratorios Ojer Pharma S.L. (Pharmaceutical company). Phase: Therapeutic confirmatory (Phase III). Countries: Poland (ongoing, recruiting).
Therapeutic area(s): Diseases [C] - Virus Diseases [C02]
Gender: Female, Male. Age: 18-64 years, 65+ years. Enrolment: 200.
Status: Ongoing, recruiting. Start date (EU): 2025-01-15. Decision date: 2024-10-07. Results received: No. Last updated: 2026-03-31.
Decision dates by country: PL: 2024-11-25

Condition(s): Recurrent herpes labialis (RHL)
Product: Zovirax 50 mg/g crema, Lipovir 50 mg/g Gel, Placebo

Primary endpoint: Duration of Episode (DOE) assessed by the investigator based on clinical observation and review of participant diary. For vesicular lesions, DOE is the time from treatment initiation to the healing (loss of crust; residual erythema may be present). For not vesicular lesions, DOE is the time from treatment initiation to the return to normal skin or to cessation of symptoms, whichever occurs last.
Endpoint(s): Local product tolerability self-reported by the participant, Product acceptability as assessed by the participant, Incidence of adverse events

Source: https://euclinicaltrials.eu/ctis-public/view/2023-510338-10-00